EU clinical trial 2023-505608-43-00: A Phase 2b, Double-Blind, Placebo-Controlled Study to Evaluate Eltrekibart in Adult Participants with Moderate to Severe Hidradenitis Suppurativa
Protocol code: I7P-MC-DSAF
Sponsor: Eli Lilly & Co. (Pharmaceutical company). Phase: Therapeutic exploratory (Phase II). Countries: Germany (ongoing, recruitment ended), Poland (ongoing, recruitment ended), Greece (ongoing, recruitment ended).
Therapeutic area(s): Diseases [C] - Immune System Diseases [C20]
Gender: Female, Male. Age: 18-64 years, 65+ years. Enrolment: 90.
Status: Ongoing, recruitment ended. Start date (EU): 2024-07-04. Decision date: 2024-06-17. Results received: No. Last updated: 2026-04-01.
Decision dates by country: PL: 2024-06-24, GR: 2024-06-21, DE: 2024-06-17

Condition(s): Moderate to Severe Hidradenitis Suppurativa
Product: Eltrekibart, 0.9% sodium chloride

Primary endpoint: Percentage of Participant Achieving Hidradenitis Suppurativa Clinical Response 50 (HiSCR50) [Time Frame: Week 16]

Source: https://euclinicaltrials.eu/ctis-public/view/2023-505608-43-00